EU clinical trial 2024-514786-19-01: Translational research study to discover molecular changes in patients with localized prostate cancer undergoing robotic-assisted radical prostatectomy and treated for 4 weeks with Enzalutamide compared to those not treated with Enzalutamide
Protocol code: PROSEMA
Sponsor: Asociacion Instituto De Investigacion Sanitaria Biobizkaia (Laboratory/Research/Testing facility). Phase: Therapeutic use (Phase IV). Countries: Spain (ongoing, recruitment ended).
Therapeutic area(s): Diseases [C] - Male Urogenital Diseases [C12]
Gender: Male. Age: 18-64 years, 65+ years. Enrolment: 30.
Status: Ongoing, recruitment ended. Start date (EU): 2025-01-27. Decision date: 2024-09-18. Results received: No. Last updated: 2026-05-04.

Condition(s): PROSTATE CANCER
Product: Xtandi - 40 mg soft capsules

Primary endpoint: analyze molecular alterations

Source: https://euclinicaltrials.eu/ctis-public/view/2024-514786-19-01